EU clinical trial 2024-516110-38-00: PHITT: Paediatric Hepatic International Tumour Trial
Protocol code: RG_15-114
Sponsor: The University Of Birmingham (Educational Institution). Phase: Therapeutic confirmatory (Phase III). Countries: Poland (ongoing, recruiting), Germany (ongoing, recruiting), France (ongoing, recruiting), Belgium (ongoing, recruiting), Ireland (ongoing, recruiting), Spain (ongoing, recruiting), Norway (ongoing, recruiting), Czechia (ongoing, recruiting), Netherlands (ongoing, recruiting), Austria (ongoing, recruiting).
Therapeutic area(s): Diseases [C] - Neoplasms [C04]
Gender: Female, Male. Age: 0-17 years, 18-64 years. Enrolment: 292.
Status: Ongoing, recruiting. Start date (EU): 2018-03-06. Decision date: 2025-01-21. Results received: No. Last updated: 2026-07-14.
Decision dates by country: AT: 2025-01-27, BE: 2025-01-21, CZ: 2025-01-24, FR: 2025-01-23, IE: 2025-01-21, ES: 2025-01-22, PL: 2025-01-27, DE: 2025-01-23, NO: 2025-01-21, NL: 2025-01-23

Condition(s): Hepatoblastoma and Hepatocellular Carcinoma
Product: ETOPOSIDE, ETOPOSIDE, DOXORUBICIN HYDROCHLORIDE, VINCRISTINE SULFATE, ETOPOSIDE, ETOPOSIDE, CISPLATIN, VINCRISTINE SULFATE, DOXORUBICIN HYDROCHLORIDE, FLUOROURACIL, OXALIPLATIN, IRINOTECAN, ETOPOSIDE, CISPLATIN, SORAFENIB, DOXORUBICIN HYDROCHLORIDE, CARBOPLATIN, FLUOROURACIL, ETOPOSIDE, FLUOROURACIL, DOXORUBICIN HYDROCHLORIDE, CISPLATIN, CARBOPLATIN, FLUOROURACIL, CISPLATIN, FLUOROURACIL, ETOPOSIDE, GEMCITABINE HYDROCHLORIDE, OXALIPLATIN, CARBOPLATIN, DOXORUBICIN HYDROCHLORIDE, CISPLATIN, CARBOPLATIN, DOXORUBICIN HYDROCHLORIDE, OXALIPLATIN, OXALIPLATIN, CARBOPLATIN, FLUOROURACIL

Primary endpoint: Event Free Survival (EFS) as defined as the time from randomisation (or registration into the trial for non-randomised patients) to the first failure event. Patients who have not had an event will be censored at their last follow-up date., Progression of existing disease or occurrence of disease at new sites, Death from any cause prior to disease progression, Diagnosis of a second malignant neoplasm., Response in HCC is defined as complete (CR) or partial (PR) response according to RECIST version 1.1 criteria. The assessment will be performed after 3 cycles of PLADO, or 4 cycles of PLADO+S/GEMOx+S in Group F patients. Patients who are not assessable for response, e.g. because of early stopping of treatment or death, will be assumed to be non-responders.
Endpoint(s): Failure-free survival (FFS): defined as per EFS (above) with the addition of failure to go to resection., Overall survival (OS): defined as the time from randomisation (or enrolment for non-randomised patients) to death from any cause. Patients who have not died will be censored at their last follow-up date., Toxicity will be recorded in relation to each cycle of randomised treatment and will be categorised and graded using Common Terminology Criteria for Adverse Events (CTCAE), Chemotherapy-related cardiac, nephro- and oto- toxicity will be recorded in relation to each cycle of non-randomised treatment and will be categorised and graded using common terminology criteria for adverse events (CTCAE), Hearing loss will be measured according to the SIOP Boston Scale for oto-toxicity. The assessment will be performed at end of treatment and follow up., Best Response as defined as Complete Response (CR) and Progressive Response (PR) and is defined in the protocol (Appendix 8) based on radiological response and AFP decline. Best response will be measured throughout treatment period and follow up. Patients who are not assessable for response , e.g. because of early stopping of treatment or death - will be assumed non-responders, Surgical resectability as defined as complete resection, partial resection or transplant following randomisation (or enrolment for non-randomised patients).

Source: https://euclinicaltrials.eu/ctis-public/view/2024-516110-38-00